EU clinical trial 2024-514970-27-00: An Open-Label, Randomized, Cross-Over Study to Investigate the Efficacy and Safety of Mexiletine PR compared to Mexiletine IR in Patients with Non-Dystrophic Myotonias (ACHILLES study)
Protocol code: MEX-NDM-301
Sponsor: Lupin Atlantis Holdings S.A. (Pharmaceutical company). Phase: Therapeutic confirmatory (Phase III). Countries: Germany (authorised, recruitment pending), Italy (ongoing, recruiting), Belgium (ongoing, recruiting), France (ongoing, recruiting).
Therapeutic area(s): Phenomena and Processes [G] - Musculoskeletal and Neural Physiological Phenomena [G11]
Gender: Female, Male. Age: 0-17 years, 18-64 years, 65+ years. Enrolment: 20.
Start date (EU): 2025-09-03. Decision date: 2025-02-14. Results received: No. Last updated: 2026-05-02.
Decision dates by country: IT: 2025-02-19, DE: 2025-02-18, BE: 2025-02-14, FR: 2025-02-20

Condition(s): Non-Dystrophic Myotonias (NDM)
Product: Namuscla 167 mg hard capsules, Mexiletine granules for prolonged-release oral suspension 167 mg, Mexiletine granules for prolonged-release oral suspension 500 mg, Mexiletine granules for prolonged-release oral suspension 333 mg

Primary endpoint: Incidence of treatment emergent Adverse Events (TEAEs), treatment-related TEAEs, serious AEs, AEs of Special Interest (AESIs), and patient discontinuation rate between mexiletine PR and mexiletine IR after 12 weeks of treatment.
Endpoint(s): Video-recording of hand opening time (VHOT), Individualized Neuromuscular Quality of Life Questionnaire (INQoL), Myotonia Behavior Scale (MBS), Timed “Up & Go” (TUG) Test, Visual Analog Scale (VAS) for myotonia/stiffness, Clinical Global Impression (CGI) – Efficacy, Clinical Global Impression (CGI) – Tolerability Index

Source: https://euclinicaltrials.eu/ctis-public/view/2024-514970-27-00